EU clinical trial 2025-522525-34-00: Effect of Semaglutide on embryo quality in overweight and obese patients undergoing In Vitro Fertilization. A Randomized Controlled Trial
Sponsor: Santiago Dexeus Font Fundacio Privada (Laboratory/Research/Testing facility). Phase: Therapeutic use (Phase IV). Countries: Spain (ongoing, recruiting).
Therapeutic area(s): Diseases [C] - Female Urogenital Diseases and Pregnancy Complications [C13]
Gender: Female. Age: 18-64 years. Enrolment: 62.
Status: Ongoing, recruiting. Start date (EU): 2026-01-19. Decision date: 2025-10-24. Results received: No. Last updated: 2025-10-24.

Condition(s): Infertility
Product: Wegovy 1 mg solution for injection in pre-filled pen, Ganirelix Gedeon Richter 0.25 mg/0.5 mL solution for injection in pre-filled syringe, Bemfola 300 IU/0.50 mL solution for injection in pre-filled pen, Decapeptyl diario 0,1 mg polvo y disolvente para solución inyectable

Primary endpoint: Number of good quality blastocysts
Endpoint(s): Days of stimulation, Total dose of Gonadotropins, Number Cumulus-oocyte complex (COCs), Number MII, Fertilization rate, Time of appearance of the 2nd polar body (tPB2), Time of pronuclei appearance (tPNa), Evaluation of both pronuclei (PN), Time of pronuclei disappearance (tPNf), Time of division from 2 to 8 cells (t2, t3, t4, t5, t6, t7, t8), Time of compaction (tSC), Time of morula (tM), Time of cavitation (tSB), Time of full blastulation (tB), Total number of day 5 blastocysts, Blastocyst formation rate, defined as the proportion of 2PN zygotes that reach the blastocyst stage, Number of embryos cryopreserved, Embryo stage (D5, D6, D7), Ovarian reserve markers (Antral Follicle Count,(AFC), Antimullerian Hormone (AMH)) before and after the treatment with semaglutide, Change in body weight and BMI, before and after the treatment with semaglutide, Change in WC, before and after the treatment with semaglutide

Source: https://euclinicaltrials.eu/ctis-public/view/2025-522525-34-00